EU clinical trial 2022-502319-12-00: A study to learn how safe the study treatment BAY3401016 is, how it affects the body and how it moves into, through, and out of the body when a single amount is given to healthy male participants
Protocol code: 21891
Sponsor: Bayer AG (Pharmaceutical company). Phase: Human Pharmacology (Phase I)- First administration to humans. Countries: Germany (ended).
Therapeutic area(s): Diseases [C] - Cardiovascular Diseases [C14]
Gender: Male. Age: 18-64 years. Enrolment: 126.
Status: Ended. Start date (EU): 2023-05-30. End date (EU): 2025-12-16. Decision date: 2023-04-21. Results received: No. Last updated: 2025-07-25.

Condition(s): Alport syndrome

Source: https://euclinicaltrials.eu/ctis-public/view/2022-502319-12-00